EU clinical trial 2024-519844-34-03: Advancing PRecise Interventions for resistant DEpression: rebalancing brain networks and investigating the trajectories of antidepressant effect with psilocybin and personalized neuromodulation (PRIDE)
Sponsor: Universita' Degli Studi G. D'Annunzio Di Chieti (Educational Institution). Phase: Therapeutic exploratory (Phase II). Countries: Italy (ongoing, recruiting).
Therapeutic area(s): Psychiatry and Psychology [F] - Mental Disorders [F03]
Gender: Female, Male. Age: 18-64 years. Enrolment: 68.
Status: Ongoing, recruiting. Start date (EU): 2026-01-19. Decision date: 2025-07-08. Results received: No. Last updated: 2025-11-19.

Condition(s): Treatment Resistant Depression (TRD)
Product: PCB2 (inert placebo containing maltodextrin), PEX010 Psilocybin Capsules (25mg psilocybin)

Primary endpoint: Non-inferiority (with a 25% margin) in terms of percentage of clinical responders, defined as the reduction in Montgomery-Asberg Depression Rating Scale (MADRS) scores ≥ 50%, after 60 days from the start of the trial.
Endpoint(s): Hamilton Anxiety Rating Scale (HAM-A) score, Hamilton Depression Rating Scale (HAM-D) score, Brief Psychiatric Rating Scale (BPRS) score, Young Mania Rating Scale (YMRS) score, Snaith-Hamilton Pleasure Scale (SHAPS) scores for anhedonia, Columbia–Suicide Severity Rating Scale and Beck Hopelessness Scale scores for suicide risk, Trail Making Test for attention and executive functions, Clinical Global Impression Severity (CGIS) and Health Status Questionnaire scores for impact of symptoms on health, Functional magnetic resonance imaging (fMRI) analysis for changes in connectivity patterns in TRD-related brain networks, Electroencephalography (EEG) for changes in functional connectivity

Source: https://euclinicaltrials.eu/ctis-public/view/2024-519844-34-03